EU clinical trial 2025-522373-10-00: IM0271016: An Open-label, Multi-center, Long-term Extension Study to Evaluate the Long-term Safety and Tolerability of Admilparant in Participants with Pulmonary Fibrosis
Protocol code: IM0271016
Sponsor: Bristol-Myers Squibb Services Unlimited Company (Pharmaceutical company). Phase: Therapeutic confirmatory (Phase III). Countries: Finland (authorised, recruitment pending), Portugal (authorised, recruitment pending), Hungary (authorised, recruitment pending), Ireland (authorised, recruitment pending), Poland (authorised, recruitment pending), Greece (authorised, recruitment pending), France (authorised, recruitment pending), Belgium (authorised, recruitment pending), Denmark (authorised, recruitment pending), Italy (authorised, recruitment pending), Spain (authorised, recruitment pending), Netherlands (authorised, recruitment pending), Austria (authorised, recruitment pending), Germany (authorised, recruitment pending).
Therapeutic area(s): Diseases [C] - Respiratory Tract Diseases [C08]
Gender: Female, Male. Age: 18-64 years, 65+ years. Enrolment: 318.
Status: Authorised, recruitment pending. Decision date: 2026-06-17. Results received: No. Last updated: 2026-08-04.
Decision dates by country: BE: 2026-06-17, DK: 2026-06-17, FI: 2026-06-17, DE: 2026-06-18, HU: 2026-06-19, IE: 2026-06-22, IT: 2026-06-17, PT: 2026-06-18, ES: 2026-06-19, NL: 2026-06-17, PL: 2026-06-18, GR: 2026-08-04, FR: 2026-08-04, AT: 2026-06-21

Condition(s): Progressive pulmonary fibrosis and Idiopathic pulmonary fibrosis
Product: LPA1 antagonist, LPA1 antagonist, BMS-986278

Primary endpoint: Track the number of side effects that happen after starting the treatment, including serious side effects, side effects that cause someone to stop taking the medicine, and any deaths., Assess changes in lab test results, heart tests (ECG), and vital signs like blood pressure and heart rate over time and compare any changes to what they were on the first day of the study.

Source: https://euclinicaltrials.eu/ctis-public/view/2025-522373-10-00